EU clinical trial 2025-521627-78-00: Phase 3, Multicenter, Randomized, Open-label Clinical Study of GSK5764227, a B7-H3 Antibody Drug Conjugate (ADC), compared with Topotecan in Participants with Relapsed Small Cell Lung Cancer (SCLC)
Protocol code: 223674
Sponsor: Glaxosmithkline Research & Development Limited (Pharmaceutical company). Phase: Therapeutic confirmatory (Phase III). Countries: Hungary (ongoing, recruiting), France (ongoing, recruiting), Portugal (ongoing, recruiting), Greece (ongoing, recruiting), Sweden (ongoing, recruiting), Ireland (authorised, recruitment pending), Poland (authorised, recruitment pending), Bulgaria (ongoing, recruiting), Romania (ongoing, recruiting), Finland (ongoing, recruiting), Italy (ongoing, recruiting), Germany (ongoing, recruiting), Spain (ongoing, recruiting).
Therapeutic area(s): Diseases [C] - Neoplasms [C04]
Gender: Female, Male. Age: 18-64 years, 65+ years. Enrolment: 210.
Start date (EU): 2026-01-28. Decision date: 2025-09-29. Results received: No. Last updated: 2026-06-15.
Decision dates by country: PL: 2025-10-06, BG: 2025-10-06, FR: 2025-10-03, FI: 2025-10-09, ES: 2025-10-01, RO: 2025-10-06, DE: 2025-10-01, IE: 2025-10-03, HU: 2025-10-02, IT: 2025-10-01, SE: 2025-09-30, GR: 2025-10-03, PT: 2025-09-29

Condition(s): Neoplasms, Lung
Product: TOPOTECANE ACCORD 1 mg/ml, solution à diluer pour perfusion, HYCAMTIN 0.25 mg hard capsules, HYCAMTIN 1 mg hard capsules, TOPOTECANE ACCORD 1 mg/ml, solution à diluer pour perfusion

Primary endpoint: OS, defined as the time from the date of randomization to the date of death by any cause

Source: https://euclinicaltrials.eu/ctis-public/view/2025-521627-78-00